EU clinical trial 2024-515020-36-00: A Clinical Trial for Patients with Advanced Cancers
Sponsor: Corbus Pharmaceuticals Inc. (Pharmaceutical company). Phase: Phase I and Phase II (Integrated)- Other. Countries: Spain (ongoing, recruiting), Italy (ongoing, recruiting), Romania (ongoing, recruiting), France (ongoing, recruiting).
Therapeutic area(s): Diseases [C] - Immune System Diseases [C20]; Diseases [C] - Neoplasms [C04]
Gender: Female, Male. Age: 18-64 years, 65+ years. Enrolment: 128.
Status: Ongoing, recruiting. Start date (EU): 2025-02-24. Decision date: 2025-01-27. Results received: No. Last updated: 2026-03-16.
Decision dates by country: RO: 2025-02-03, FR: 2025-01-29, ES: 2025-01-27, IT: 2025-01-29

Condition(s): Advanced Solid tumour

Source: https://euclinicaltrials.eu/ctis-public/view/2024-515020-36-00